EU clinical trial 2024-516717-20-00: An open-label, multicentric, phase I study with expansion cohorts, evaluating the safety and the efficacy of combination of atezolizumab, tiragolumab and stereotactic body radiation therapy in patients with metastatic multiorgan cancer
Sponsor: Centr Georges Francois Leclerc (Hospital/Clinic/Other health care facility). Phase: Human Pharmacology (Phase I)- Other. Countries: France (ongoing, recruitment ended).
Therapeutic area(s): Diseases [C] - Digestive System Diseases [C06]
Gender: Female, Male. Age: 18-64 years, 65+ years. Enrolment: 86.
Status: Ongoing, recruitment ended. Start date (EU): 2024-11-27. Decision date: 2024-11-27. Results received: No. Last updated: 2026-07-16.

Condition(s): Metastatic renal cell carcinoma : For expansion cohort, Metastatic bladder cancer : For expansion cohort, Metastatic head and neck carcinoma : For expansion cohort, Metastatic non small cell lung cancer (Phase I and expansion cohorts)

Source: https://euclinicaltrials.eu/ctis-public/view/2024-516717-20-00